EU clinical trial 2025-521696-31-00: DOSABEMA-Pharmacokinetic model of abemaciclib: correlation with severe diarrhea as the primary toxicity endpoint in patients with hormone receptor-positive localized breast cancer
Protocol code: DOSABEMA
Sponsor: Centre Hospitalier Universitaire De Poitiers (Hospital/Clinic/Other health care facility). Phase: Therapeutic use (Phase IV). Countries: France (authorised, recruitment pending).
Therapeutic area(s): Diseases [C] - Neoplasms [C04]
Gender: Female. Age: 18-64 years, 65+ years. Enrolment: 235.
Status: Authorised, recruitment pending. Decision date: 2026-01-06. Results received: No. Last updated: 2026-07-08.

Condition(s): HR+, HER2- breast cancer at high risk of recurrence
Product: Verzenios 150 mg film-coated tablets, Verzenios 100 mg film-coated tablets, Verzenios 50 mg film-coated tablets

Primary endpoint: The probability of severe diarrhoea (grades 2, 3 and 4 according to CTCAE v5.0) occurring as a result of exposure to abemaciclib and its metabolites will be characterised by a mixed-effects joint model, combining longitudinal, pharmacokinetic (continuous) and toxicity (survival) data.
Endpoint(s): The probability of severe neutropenia (grades 3 and 4 according to the current CTCAE) occurring as a result of exposure to abemaciclib and its metabolites will be characterised by a mixed-effects joint model, combining longitudinal pharmacokinetic data pharmacokinetic (continuous type) and pharmacodynamic (neutrophil concentration, continuous type) data., Validation of the mixed-effects PK/PD model using standard diagnostic tools (diagnostic plots of data fit, visual predictive checks, estimation precision, shrinkage)., The ‘fu’ of abemaciclib concentrations will be modelled within the mixed-effects PK/PD model, and any correlation with clinical and biological covariates will be evaluated.

Source: https://euclinicaltrials.eu/ctis-public/view/2025-521696-31-00